EU clinical trial 2023-504879-24-00: In vivo bioequivalence study of a new clobetasol propionate 0.05% topical cream compared to DERMOVAL® 0.05% cream using the skin blanching bioassay in healthy subjects.
Sponsor: Substipharm (Pharmaceutical company). Phase: Human Pharmacology (Phase I)- Bioequivalence Study. Countries: France (ended).
Therapeutic area(s): Diseases [C] - Skin and Connective Tissue Diseases [C17]
Gender: Female, Male. Age: 18-64 years. Enrolment: 102.
Status: Ended. Start date (EU): 2023-12-12. End date (EU): 2024-07-25. Decision date: 2023-10-30. Results received: No. Last updated: 2023-10-30.

Condition(s): corticosteroid-sensitive dermatosis

Source: https://euclinicaltrials.eu/ctis-public/view/2023-504879-24-00